EU clinical trial 2024-513122-27-00: A Multicenter, Randomized, Open-Label, Phase 3 Trial of Trastuzumab Deruxtecan (Enhertu®) Plus Chemotherapy Plus or Minus Pembrolizumab versus Chemotherapy Plus Trastuzumab Plus Or Minus Pembrolizumab as First-Line Treatment in Participants with Unresectable, Locally Advanced or Metastatic HER2-Positive Gastric or Gastroesophageal Junction (GEJ) Cancer (DESTINY-Gastric05)
Protocol code: DS8201-724
Sponsor: Daiichi Sankyo Inc. (Pharmaceutical company). Phase: Therapeutic confirmatory (Phase III). Countries: Portugal (ongoing, recruiting), Belgium (ongoing, recruiting), Germany (ongoing, recruiting), Czechia (ongoing, recruiting), Italy (ongoing, recruiting), Spain (ongoing, recruiting), Netherlands (ongoing, recruiting), France (ongoing, recruiting), Norway (ongoing, recruiting), Austria (ongoing, recruiting), Poland (ongoing, recruiting), Romania (ongoing, recruiting).
Therapeutic area(s): Diseases [C] - Digestive System Diseases [C06]
Gender: Female, Male. Age: 18-64 years, 65+ years. Enrolment: 214.
Status: Ongoing, recruiting. Start date (EU): 2025-06-10. Decision date: 2025-04-29. Results received: No. Last updated: 2026-03-27.
Decision dates by country: RO: 2025-07-21, AT: 2025-05-06, CZ: 2025-04-30, IT: 2025-04-30, DE: 2025-05-02, NL: 2025-05-01, BE: 2025-04-29, NO: 2025-05-05, FR: 2025-05-06, PT: 2025-04-30, PL: 2025-05-05, ES: 2025-04-30

Condition(s): Unresectable, Locally Advanced or Metastatic HER2 positive Gastric or Gastroesophageal Junction Cancer
Product: Herzuma 150 mg powder for concentrate for solution for infusion, KEYTRUDA 25 mg/mL concentrate for solution for infusion, DS-8201a, CAPECITABINE, 5-Fluorouracil Ebewe 50 mg/ml concentrat pentru soluţie injectabilă/perfuzabilă, Cisplatin Hikma 1 mg/ml Konzentrat zur Herstellung einer Infusionslösung, CAPECITABINE, Oxaliplatin AqVida 5 mg/ml Konzentrat zur Herstellung einer Infusionslösung

Primary endpoint: PFS is defined as the time interval from the date of randomization to the date of radiographic disease progression or death due to any cause.
Endpoint(s): OS is defined as the time interval from the date of randomization to the date of death due to any cause., Incidence of TEAEs, SAEs, AESIs, deaths, ECOG performance status, vital signs, clinical laboratory results, ECGs, and ECHO/MUGA results., ORR is defined as the proportion of participants with a BOR of confirmed CR or confirmed PR according to RECIST v1.1., PFS is defined as the time interval from the date of randomization to the date of disease progression or death due to any cause. Disease progression will be determined by investigators’ assessment of tumor scans according to RECIST v1.1., DoR is defined as the time from the date of first documentation of objective tumor response (CR or PR) for responding participants (CR or PR) only to the first documentation of objective tumor progression or death due to any cause., TTR is defined as the time from the date of randomization to the date of the first documentation of objective response (CR or PR). Time to response will be measured for responding participants (CR or PR) only., PFS2 is defined as the time from the date of randomization to the first documented progression on next-line therapy or death due to any cause., Serum concentrations of T-DXd, total anti-HER2-antibody, and DXd., The proportion of participants having treatment-emergent ADA. Titer and neutralizing antibodies will be determined when ADA is positive., Time to confirmed deterioration and change from baseline in the following measure: • FACT-GA subscale, Time to confirmed deterioration and change from baseline in the following measure: • FACT-GA Physical Well-being subscale, Time to confirmed deterioration and change from baseline in the following measure: • EQ-5D-5L VAS

Source: https://euclinicaltrials.eu/ctis-public/view/2024-513122-27-00